EU clinical trial 2023-504753-12-00: A randomized, multicenter, double-blind, Phase 3 study to investigate the safety and efficacy of belrestotug in combination with dostarlimab compared with placebo in combination with pembrolizumab in participants with previously untreated, locally advanced, unresectable or metastatic PD-L1 selected non small cell lung cancer (GALAXIES LUNG 301)
Protocol code: 213823
Sponsor: Glaxosmithkline Research & Development Limited (Pharmaceutical company). Phase: Therapeutic confirmatory (Phase III). Countries: Italy (ended), Belgium (ended), Romania (ended), Portugal (ended), Netherlands (ended), Finland (ended), Spain (ongoing, recruitment ended), Czechia (ended), Bulgaria (ended), Germany (ended), France (ongoing, recruitment ended), Greece (ended), Poland (ended), Sweden (ended), Hungary (ended), Croatia (ended), Estonia (ended), Slovenia (ended), Norway (ended), Slovakia (ended).
Therapeutic area(s): Diseases [C] - Neoplasms [C04]
Gender: Female, Male. Age: 18-64 years, 65+ years. Enrolment: 328.
Start date (EU): 2024-10-01. Decision date: 2024-07-29. Results received: No. Last updated: 2026-05-07.
Decision dates by country: BE: 2024-07-30, CZ: 2024-08-01, PL: 2024-07-30, IT: 2024-07-30, GR: 2024-09-10, DE: 2024-07-31, HR: 2025-05-19, EE: 2025-05-16, SI: 2025-04-09, NO: 2025-04-14, SK: 2025-05-12, NL: 2024-08-02, PT: 2024-08-01, RO: 2024-09-04, HU: 2024-09-10, BG: 2024-07-30, ES: 2024-07-29, FI: 2024-07-30, SE: 2024-09-10, FR: 2024-09-10

Condition(s): Lung Cancer, Non-Small Cell
Product: 0.9% Sodium Chloride for Injection, KEYTRUDA 25 mg/mL concentrate for solution for infusion, KEYTRUDA 25 mg/mL concentrate for solution for infusion., JEMPERLI 500 mg concentrate for solution for infusion

Primary endpoint: • Incidence of TEAEs and SAEs, • Incidence of TEAEs/SAEs leading to dose withdrawals or treatment discontinuations

Source: https://euclinicaltrials.eu/ctis-public/view/2023-504753-12-00